EU clinical trial 2024-514619-88-00: P3-IMU-838-RMS-02 - A Multi-Center, Randomized, Double-Blinded Phase 3 Study to Evaluate the Efficacy, Safety, and Tolerability of IMU-838 versus Placebo in Adults with Relapsing Multiple Sclerosis (ENSURE-2)
Protocol code: P3-IMU-838-RMS-02
Sponsor: Immunic AG (Pharmaceutical company). Phase: Therapeutic confirmatory (Phase III). Countries: Romania (ongoing, recruitment ended), Germany (ended), Estonia (ongoing, recruitment ended), Poland (ongoing, recruitment ended).
Therapeutic area(s): Diseases [C] - Nervous System Diseases [C10]
Gender: Female, Male. Age: 18-64 years. Enrolment: 339.
Start date (EU): 2022-03-18. Decision date: 2024-10-04. Results received: No. Last updated: 2026-07-27.
Decision dates by country: EE: 2024-10-07, DE: 2024-10-04, RO: 2024-10-09, PL: 2024-10-07

Condition(s): Relapsing Multiple Sclerosis
Product: IMU-838 30 mg tablet, IMU-838 15 mg tablets, Placebo for IMU-838 Tablets

Primary endpoint: Time to first confirmed relapse, as determined by the Independent Neurology Evaluation Committee (INEC), relapse occurred after the start of treatment administration and before the end of the main period (EOMP)
Endpoint(s): Key secondary efficacy: 1) Total number of new and / or enlarging T2-MRI lesions from baseline (BL, SV2) until Week 48

Source: https://euclinicaltrials.eu/ctis-public/view/2024-514619-88-00